EU clinical trial 2024-512914-16-00: A Randomized, Double-blind, Parallel-group Study to Compare Pharmacokinetics, Pharmacodynamics, Clinical Effects, and Safety between ABP 692 and Ocrevus® (Ocrelizumab) in Subjects with Relapsing-remitting Multiple Sclerosis
Protocol code: 20230309
Sponsor: Amgen Inc. (Pharmaceutical company). Phase: Therapeutic confirmatory (Phase III). Countries: Germany (ongoing, recruitment ended), Spain (ongoing, recruitment ended), Czechia (ongoing, recruitment ended), Sweden (temporarily halted), Lithuania (temporarily halted), Belgium (temporarily halted), Denmark (ongoing, recruitment ended), Italy (ended), Bulgaria (ongoing, recruitment ended), Slovakia (ongoing, recruitment ended), Croatia (ongoing, recruitment ended), France (ended), Poland (ongoing, recruitment ended), Slovenia (ended), Romania (ongoing, recruitment ended).
Therapeutic area(s): Diseases [C] - Nervous System Diseases [C10]
Gender: Female, Male. Age: 18-64 years. Enrolment: 375.
Start date (EU): 2025-09-12. Decision date: 2025-03-18. Results received: No. Last updated: 2026-05-25.
Decision dates by country: BE: 2025-03-18, SE: 2025-03-21, CZ: 2025-03-19, ES: 2025-03-18, PL: 2025-03-24, DK: 2025-03-19, HR: 2025-03-24, RO: 2026-02-09, SI: 2025-11-13, BG: 2025-03-24, IT: 2025-03-20, DE: 2025-03-19, LT: 2025-03-20, FR: 2025-03-21, SK: 2025-03-24

Condition(s): Relapsing-remitting Multiple Sclerosis
Product: Ocrevus 300 mg concentrate for solution for infusion, Ocrevus, ABP 692

Primary endpoint: Area under the serum concentration-time curve (AUC) from time 0 to day 15 (AUC0-d15) following infusion 1 of the initial dose, AUC from time 0 extrapolated to infinity (AUC0-inf) of the entire initial dose, Total number of new GdE T1-weighted lesions (assessed by brain MRI) over weeks 4, 8, 12, 16, 20, and 24

Source: https://euclinicaltrials.eu/ctis-public/view/2024-512914-16-00